EU clinical trial 2023-506548-18-00: A long-term extension study to evaluate the long-term safety, tolerability and efficacy of subcutaneous amlitelimab in participants of previous amlitelimab clinical trials in moderate to severe atopic dermatitis
Protocol code: LTS17367
Sponsor: Sanofi-Aventis Recherche & Developpement (Pharmaceutical company). Phase: Phase II and Phase III (Integrated). Countries: Poland (ongoing, recruiting), Czechia (ongoing, recruiting), Hungary (ongoing, recruiting), Spain (ongoing, recruiting), Germany (ongoing, recruitment ended), Bulgaria (ongoing, recruiting), Denmark (ongoing, recruiting), France (ongoing, recruiting), Greece (ongoing, recruiting), Italy (ongoing, recruiting), Portugal (ongoing, recruiting), Sweden (ended), Netherlands (ended).
Therapeutic area(s): Diseases [C] - Immune System Diseases [C20]
Gender: Female, Male. Age: 0-17 years, 18-64 years, 65+ years. Enrolment: 457.
Start date (EU): 2022-11-10. Decision date: 2024-01-08. Results received: No. Last updated: 2026-08-05.
Decision dates by country: SE: 2024-12-19, DK: 2025-01-21, NL: 2025-02-02, BG: 2024-02-19, GR: 2025-01-28, ES: 2024-01-08, HU: 2024-01-09, PL: 2024-01-10, IT: 2025-02-03, DE: 2024-01-09, CZ: 2024-01-09, FR: 2024-12-03, PT: 2024-12-10

Condition(s): Dermatitis atopic
Product: Amlitelimab, Amlitelimab, Amlitelimab

Primary endpoint: Percentage of participants who experienced treatment-emergent adverse event (TEAE)
Endpoint(s): Percentage of participants who experienced treatment-emergent serious adverse events (SAEs), Percentage of participants who experienced treatment-emergent adverse events of special interest (AESI), Absolute change from DRI17366 baseline in EASI score at each LTS17367 visit in participants entering the study from DRI17366 Week 24, Percent change from DRI17366 baseline in EASI score at each LTS17367 visit in participants entering the study from DRI17366 Week 24, Proportion of participants with EASI50/EASI75/EASI90 from DRI17366 baseline at each LTS17367 visit in participants entering the study from DRI17366 Week 24, Proportion of participants with a response of Validated Investigator Global Assessment scale for atopic dermatitis (vIGA-AD) 0 or 1 at each LTS17367 visit in participants entering the study from DRI17366 Week 24, Absolute change from feeder study baseline in EASI score in all participants entering the study [each LTS17367 visit], Percent change from feeder study baseline in EASI score in all participants entering the study [each LTS17367 visit], Proportion of participants with EASI50/ EASI75/EASI90 in all participants entering the study [each LTS17367 visit], Time to first EASI75/EASI90 in those participants who had not achieved it by the time of LTS17367 enrollment, Serum amlitelimab concentration assessed at prespecified time points through the end of the study, Number of participants with anti drug antibodies (ADAs) of amlitelimab at specified timepoints, Percentage of participants who experienced TEAE leading to treatment discontinuation, Proportion of participants with vIGA-AD 0 or 1 with presence of only barely perceptible erythema (no induration/papulation, no lichenification, no oozing or crusting) at each LTS17367 visit, Proportion of participants requiring topical treatment in all participants entering the study [each LTS17367 visit], Proportion of participants requiring rescue treatment [each LTS17367 visit]: all treatments in all participants entering the study, Time from enrollment in LTS17367 to first loss of vIGA-AD 0 in those participants who were vIGA-AD 0 at LTS17367 rollover from EFC17600 (ESTUARY) and EFC17599 (AQUA), Proportion of participants with vIGA-AD score 0/1 in all participants entering the study [each LTS17367 visit], Proportion of participants with vIGA-AD score 0 [each LTS17367 visit], Time to first vIGA-AD 0/1 after LTS17367 enrollment in those participants who had not achieved vIGA-AD 0/1 by the time of LTS17367 enrollment, Number of days on topical medication (per patient-year) in all participants entering the study, Change coming from feeder study baseline atopic dermatitis control tool (ADCT) in all participants entering the study [each LTS17367 visit], Change from feeder study baseline in dermatology life quality index (DLQI/cDLQI) in all participants entering the study [each LTS17367 visit], Change from feeder study baseline^ in patient oriented eczema measure (POEM) in all participants entering the study [each LTS17367 visit], Change from feeder study baseline in BSA-AD [each LTS17367 visit], Time from enrollment in LTS17367 to first loss EASI75 in those participants who had reached EASI75 at LTS17367 rollover coming from EFC17600 (ESTUARY) and EFC17599 (AQUA), Time from enrollment in LTS17367 to first loss of vIGA-AD 0/1 in those participants who were vIGA-AD 0/1 at LTS17367 rollover from EFC17600 (ESTUARY) and EFC17599 (AQUA), Time from LTS17367 baseline to re-treatment with amlitelimab in those participants who were vIGA-AD 0/1 at LTS17367 rollover from EFC17600 (ESTUARY) and EFC17599 (AQUA)., Time from last amlitelimab dose in feeder study to re-treatment with amlitelimab in those participants who were vIGA-AD 0/1 at LTS17367 rollover from EFC17600 (ESTUARY) and EFC17599 (AQUA).

Source: https://euclinicaltrials.eu/ctis-public/view/2023-506548-18-00